EU clinical trial 2024-515230-32-00: A Phase 1, Open-label, Randomized, Crossover Study to Assess the Effect of Different Types of Co-administered Oral Liquids on the Relative Oral Bioavailability of a JNJ 77242113 Tablet Formulation in Healthy Participants.
Protocol code: 77242113PSO1009
Sponsor: Janssen Cilag International (Pharmaceutical company). Phase: Human Pharmacology (Phase I)- Other. Countries: Belgium (ended).
Therapeutic area(s): Diseases [C] - Immune System Diseases [C20]
Gender: Female, Male. Age: 18-64 years. Enrolment: 16.
Status: Ended. Start date (EU): 2024-10-09. End date (EU): 2024-11-29. Decision date: 2024-08-06. Results received: No. Last updated: 2024-08-06.

Condition(s): Inflammatory Conditions

Source: https://euclinicaltrials.eu/ctis-public/view/2024-515230-32-00